EU clinical trial 2026-526105-15-00: A multicenter, Randomized, Double-blind, Placebo-controlled Clinical Trial to Evaluate the Efficacy and Safety of Subcutaneous Immunotherapy (Beltavac®) with Polymerized Allergenic Extract of a Mixture of Dermatophagoides and Blomia tropicalis in Patients with Allergic Rhinitis/rhinoconjunctivitis.
Protocol code: PRO-RCT-POL-2026-02
Sponsor: Probelte Pharma S.L. (Pharmaceutical company). Phase: Therapeutic confirmatory (Phase III). Countries: Spain (authorised, recruitment pending).
Therapeutic area(s): Diseases [C] - Eye Diseases [C11]; Diseases [C] - Disorders of Environmental Origin [C21]
Gender: Female, Male. Age: 0-17 years, 18-64 years, 65+ years. Enrolment: 174.
Status: Authorised, recruitment pending. Decision date: 2026-07-08. Results received: No. Last updated: 2026-07-08.

Condition(s): Allergic rhinitis/rhinoconjunctivitis due to house dust mites exposure
Product: PLACEBO, Beltavac Polimerizado mezcla de Dermatophagoides pteronyssinus, Dermatophagoides farinae y Blomia tropicalis (1:1:1)

Primary endpoint: Combined score of nasal symptoms and specific allergy medication (CSMR4) completed by the patient daily in the patient's electronic record in 4-week periods prior to visits 1 and 7 and 8-week periods prior to visit 13.
Endpoint(s): Rhinitis Symptoms Score, Specific Medication Scale score., Nasal and Ocular Symptom Scale score., Combined score of nasal, ocular, and medication symptoms (CSMR6)., Percentage of days without symptoms or medication., Visual analogue scale score on visits 1, 7 and 13 by the patient and investigator., RCAT questionnaire score on visits 1, 7 and 13., Specific rhinitis questionnaire score (mini-RQLQ) at visits 1, 7 and 13., Specific serum values of IgE and IgG4 specific to Blomia, DPT and DF total, Der p1 and Der p2, Der p23, Der f1, Der f2 and Blo t5 at visits 0, 7 and 13.

Source: https://euclinicaltrials.eu/ctis-public/view/2026-526105-15-00